EU clinical trial 2024-517251-12-00: The BURAN Study of Buparlisib (AN2025) In Combination with Paclitaxel Compared to Paclitaxel Alone, in Patients with Recurrent or Metastatic Head and Neck Squamous Cell Carcinoma
Protocol code: AN2025H0301
Sponsor: Adlai Nortye USA Inc. (Pharmaceutical company). Phase: Therapeutic confirmatory (Phase III). Countries: Germany (ended), Italy (ended), Hungary (ended), Spain (ended), Belgium (ended), Poland (ended), France (ended).
Therapeutic area(s): Diseases [C] - Neoplasms [C04]
Gender: Female, Male. Age: 18-64 years, 65+ years. Enrolment: 202.
Status: Ended. Start date (EU): 2021-11-02. End date (EU): 2025-06-16. End date: 2025-10-07. Decision date: 2024-09-24. Results received: Yes. Last updated: 2025-08-04.
Decision dates by country: BE: 2024-09-27, FR: 2024-10-22, DE: 2024-09-26, HU: 2024-09-25, IT: 2024-09-30, PL: 2024-10-07, ES: 2024-09-24

Condition(s): Recurrent or metastatic head and neck squamous cell carcinoma
Product: Buparlisib 50mg Tablet, Buparlisib 40mg Tablet, Paclitaxel 6 mg/ml concentrate for solution for infusion, Buparlisib 50 mg Capsules, Buparlisib 10 mg Capsules

Primary endpoint: The primary endpoint of this study is OS.
Endpoint(s): Efficacy: 1. PFS 2. Overall response rate (ORR) 3. Duration of response (DoR) 4. OS, PFS, ORR and DoR in subgroups, Safety: 1. AEs 2.Clinical laboratory tests, Exploratory Endpoints: Biomarkers

Source: https://euclinicaltrials.eu/ctis-public/view/2024-517251-12-00